EU clinical trial 2024-518861-90-00: Thromboprophylaxis with apixaban during neoadjuvant therapy for muscle-invasive bladder cancer (ACB): An international randomized controlled trial evaluating apixaban versus no anticoagulation in patients scheduled to undergo radical cystectomy or chemoradiotherapy for muscle-invasive bladder cancer
Protocol code: CLUE-ACB-2024
Sponsor: HUS-Yhtymae (Hospital/Clinic/Other health care facility). Phase: Therapeutic use (Phase IV). Countries: Finland (authorised, recruitment pending).
Therapeutic area(s): Analytical, Diagnostic and Therapeutic Techniques and Equipment [E] - Therapeutics [E02]
Gender: Female, Male. Age: 18-64 years, 65+ years. Enrolment: 210.
Status: Authorised, recruitment pending. Decision date: 2026-07-27. Results received: No. Last updated: 2026-07-27.

Condition(s): Venous thromboembolism (in bladder cancer patients)
Product: APIXABAN

Primary endpoint: Primary efficacy outcome: The incidence of any objectively confirmed venous VTE, defined as the composite of any deep vein thrombosis (DVT), including distal, and/or pulmonary embolism (PE) occurring between randomization and the CT scan performed after the final dose of NAT and before radical treatment, and detected on the CT scan (performed for all) or on clinically indicated imaging, Primary safety outcome: Incidence of major bleeding occurring between randomization and the CT scan performed after the final dose of NAT and before radical treatment, defined according to modified ISTH criteria as: fatal bleeding; bleeding in a critical area or organ; bleeding causing a fall in hemoglobin to ≤70 g/L; bleeding requiring transfusion of blood; bleeding required an invasive intervention
Endpoint(s): Secondary outcome: The incidence of any objectively confirmed VTE, defined as the composite of symptomatic or incidental DVT and/or pulmonary PE occurring within 6 months from randomization, and detected on the CT scan (performed for all) after the final dose of NAT or on clinically indicated imaging, Tertiary outcome 1: Each individual component of the primary composite efficacy endpoint analyzed separately, occurring between randomization and the CT scan performed after the final dose of NAT and before radical treatment: symptomatic VTE; asymptomatic VTE; symptomatic PE; asymptomatic PE; symptomatic DVT; asymptomatic DVT, Tertiary outcome 2: Each individual component of the primary composite efficacy endpoint analyzed separately, occurring within 6 months from randomization: symptomatic VTE; asymptomatic VTE; symptomatic PE; asymptomatic PE: symptomatic DVT; asymptomatic DVT, Tertiary outcome 3: Each individual component of the primary safety endpoint analyzed separately, occurring between randomization and the CT scan performed after the final dose of NAT and before radical treatment: fatal bleeding; bleeding in a critical area or organ; bleeding causing a fall in hemoglobin to ≤70 g/L; bleeding requiring transfusion of blood; bleeding required an invasive intervention, Tertiary outcome 4: Each individual component of the primary safety endpoint analyzed separately, occurring within 6 months from randomization: fatal bleeding; bleeding in a critical area or organ; bleeding causing a fall in hemoglobin to ≤70 g/L; bleeding requiring transfusion of blood; bleeding required an invasive intervention, Tertiary outcome 5: Bleeding requiring transfusion of at least 2 units of blood, occurring between randomization and the CT scan performed after the final dose of NAT and before radical treatment, Tertiary outcome 6: Bladder irrigation to manage hematuria, occurring between randomization and the CT scan performed after the final dose of NAT and before radical treatment, Tertiary outcome 7: Unscheduled hospital visit for bleeding, occurring between randomization and the CT scan performed after the final dose of NAT and before radical treatment, Tertiary outcome 8: Any potentially drug-related SAEs, cardiac complications (serious), cerebral complications (serious), infectious complications (serious), admittance to intensive care, or other intervention for other reasons than bleeding or a thromboembolic event occurring between randomization and the CT scan performed after the final dose of NAT and before radical treatment, Tertiary outcome 9:Overall survival at 5 years from randomization, Tertiary outcome 10: Cancer-specific survival at 5 years from randomization, Tertiary outcome 11: Time from initiation of NAT to radical treatment, stratified by 3, 4 or 6 cycles of treatment, Tertiary outcome 12: Time from initiation of neoadjuvant therapy to radical surgery or chemoradiotherapy, stratified by 3 or 4 cycles of treatment, Tertiary outcome 13: Proportion of patients who did not receive radical treatment within 6 months from the initiation of neoadjuvant therapy

Source: https://euclinicaltrials.eu/ctis-public/view/2024-518861-90-00